EU clinical trial 2024-518231-11-00: Exploratory Study of Ianalumab in Adults with Primary Immune Thrombocytopenia (ITP) and Warm-antibody Autoimmune Hemolytic Anemia (wAIHA) who Have Previously Benefited from Ianalumab (VAY RE-HIT)
Protocol code: CVAY736Q12202B
Sponsor: Novartis Pharma AG (Pharmaceutical company). Phase: Therapeutic exploratory (Phase II). Countries: Germany (ended), Czechia (ended), Belgium (ended), Spain (ended), Italy (ended), Bulgaria (ended), Romania (ended), France (ended), Hungary (ended).
Therapeutic area(s): Diseases [C] - Hemic and Lymphatic Diseases [C15]
Gender: Female, Male. Age: 18-64 years, 65+ years. Enrolment: 65.
Status: Ended. End date (EU): 2026-06-26. End date: 2026-06-27. Decision date: 2025-12-08. Results received: No. Last updated: 2026-03-11.
Decision dates by country: BE: 2025-12-08, CZ: 2025-12-09, FR: 2026-03-11, DE: 2025-12-05, HU: 2025-12-10, IT: 2025-12-09, RO: 2025-12-08, ES: 2025-12-10, BG: 2025-12-10

Condition(s): Immune thrombocytopenia (ITP) Warm autoimmune hemolytic anemia (wAIHA)
Product: DANAZOL, ENTECAVIR, VAY736

Primary endpoint: ITP participants: Treatment failure free (yes, no) by 12 m after start of second course of ianalumab is defined as any of: • platelet count <30G/L later than 8 weeks from start of second course • use of rescue treatment later than 8 weeks from second course • start of new ITP treatment • death • inability to taper TPO-RA by week 24, For wAIHA participants Durable response (Hb ≥10 g/dL and ≥2 g/dL increase from baseline) for a period of at least 8 consecutive weeks, between W9 and W25 in the absence of rescue or prohibited treatment prior to that durable response achievement.
Endpoint(s): Primary ITP participants only: • Response rate and complete response rate, Primary ITP participants only: • Number and proportion of participants receiving rescue treatment and/or new ITP therapy, wAIHA participants only: • Response rate and complete response rate, wAIHA participants only: • Number and proportion of participants who received rescue treatment and/or new wAIHA therapy, for all participants: Frequency of adverse events and other safety parameters, for all participants: Number of severe infections and proportion of participants with severe infection, for all participants: Ianalumab concentration in serum, for all participants: Incidence and titer of anti-ianalumab antibodies in serum (ADA assay) over time

Source: https://euclinicaltrials.eu/ctis-public/view/2024-518231-11-00